EU clinical trial 2024-518708-29-00: MAGNETICAL - MAGNetic resonance Evaluation of Tafamidis Impact in Cardiac AmyLoidosis
Protocol code: MGNT2022
Sponsor: Unidade Local De Saude De Tras-Os-Montes E Alto Douro E.P.E. (Hospital/Clinic/Other health care facility). Phase: Therapeutic use (Phase IV). Countries: Portugal (ongoing, recruitment ended).
Therapeutic area(s): Diseases [C] - Cardiovascular Diseases [C14]
Gender: Male. Age: 18-64 years, 65+ years. Enrolment: 30.
Status: Ongoing, recruitment ended. Start date (EU): 2024-03-13. Decision date: 2024-11-06. Results received: No. Last updated: 2024-11-06.

Condition(s): Transthyretin cardiac amyloidosis
Product: Vyndaqel 61 mg soft capsules

Primary endpoint: Change from baseline at each point in CMR imaging parameters, including: ventricular volumes, mass, ejection fraction; native T1 and T2 mapping; ECV; LookLocker at 2, 5 and 10 minutes; LGE, Strain analysis and 4D flow
Endpoint(s): Frequency of heart failure related hospitalization and all-cause mortality, Change from baseline at each point in the Kansas City Cardiomyopathy, Questionnaire overall score, Change from baseline at each point in 6MWT distance, Change from baseline at each point in NT-proBNP concentration, Change from baseline at each point in NYHA classification, Change from baseline at each point in echocardiographic parameters

Source: https://euclinicaltrials.eu/ctis-public/view/2024-518708-29-00